EU clinical trial 2024-519353-11-00: Iceland Screens Treats or Prevents Multiple Myeloma (iStopMM): A nationwide phase 2 trial of patients with smoldering and active multiple myeloma (MM)
Sponsor: Landspitali (Hospital/Clinic/Other health care facility). Phase: Therapeutic exploratory (Phase II). Countries: Iceland (authorised, recruitment pending).
Therapeutic area(s): Diseases [C] - Hemic and Lymphatic Diseases [C15]
Gender: Female, Male. Age: 18-64 years. Enrolment: 80.
Status: Authorised, recruitment pending. Decision date: 2024-12-11. Results received: No. Last updated: 2026-04-22.

Condition(s): Multiple Myeloma
Product: Kyprolis 60 mg powder for solution for infusion, Revlimid 5 mg hard capsules, Dexametason Abcur 4 mg töflur

Primary endpoint: Primary: Proportion of participants diagnosed with intermediate or high risk SMM that have MRD negativity three year from study enrollment
Endpoint(s): Clinical response by IMWG, Clinical outcomes by IMWG, Safety, Correlation with correlative and clinical outcomes

Source: https://euclinicaltrials.eu/ctis-public/view/2024-519353-11-00